EU clinical trial 2023-507320-23-00: Phase 1/1b Multiple-Ascending Dose Study of DF6215 in Patients With Advanced Solid Tumors
Protocol code: DF6215-001
Sponsor: Dragonfly Therapeutics Inc. (Pharmaceutical company). Phase: Human Pharmacology (Phase I)- First administration to humans. Countries: France (ended).
Therapeutic area(s): Diseases [C] - Neoplasms [C04]
Gender: Female, Male. Age: 18-64 years, 65+ years. Enrolment: 28.
Status: Ended. Start date (EU): 2024-04-26. End date (EU): 2025-09-08. End date: 2025-11-26. Decision date: 2024-04-05. Results received: No. Last updated: 2025-08-01.

Condition(s): Advanced Solid Tumors

Source: https://euclinicaltrials.eu/ctis-public/view/2023-507320-23-00